EU clinical trial 2023-509728-16-00: The effect of amantadine as add-on therapy for motor fluctuations in advanced Parkinson’s disease: a randomized double-blinded placebo-controlled trial
Sponsor: Centre Hospitalier Universitaire De Toulouse (Hospital/Clinic/Other health care facility). Phase: Therapeutic exploratory (Phase II). Countries: France (ongoing, recruiting).
Therapeutic area(s): Diseases [C] - Nervous System Diseases [C10]
Gender: Female, Male. Age: 18-64 years, 65+ years. Enrolment: 132.
Status: Ongoing, recruiting. Start date (EU): 2025-10-10. Decision date: 2024-08-30. Results received: No. Last updated: 2026-01-23.

Condition(s): advanced Parkinson’s disease
Product: MANTADIX 100 mg, capsule, placebo d'amantadine

Primary endpoint: The main evaluation criterion is the change from baseline to end-point (3 months) in motor fluctuation (Off-time) assessed by the Hauser diaries (average of 3 consecutive days).
Endpoint(s): The change from baseline to end-point (3 months): a) Off-time responders rate ; b) The mean score of MDS-UPDRS part IV (Goetz et al., 2008b); c) The mean score of UDysRS part 2A (Goetz et al., 2008a) ; d) The mean score of New freezing of gait questionnaire (Nieuwboer et al., 2009); e) The mean score of Fatigue Severity Scale (Herlofson and Larsen, 2002; Krupp et al., 1989), MDS-UPDRS Part I-II-III (Goetz et al., 2007) f) The mean score of PDQ-39 (Jenkinson et al., 199, The safety of amantadine, expressed as: the percentage of AEs, of severe AEs, of serious AE and of patients’ discontinuation due to AEs, all over the three months of treatment., The change from baseline to week 15 in motor fluctuation (Off-time) assessed by the Hauser diaries comparing patients with GRIN2B polymorphism vs. without, patients with COMTHH vs. patients with COMTLL and in mutated GBA/LRRK2 carriers vs. no GBA/LRRK2 mutation carriers;, The number of patients able to wear the PDMonitor during the first and the second week of assessment and the Short Assessment of Patient Satisfaction on PDMonitor in advanced PD patients;, the agreement in PD monitor outcomes changes from baseline to end-point (3 month) with clinical scales changes

Source: https://euclinicaltrials.eu/ctis-public/view/2023-509728-16-00